EU clinical trial 2024-511296-15-00: A randomized, double-blind, placebo-controlled study to evaluate the efficacy and safety of each of two dose levels of sarilumab in adults with early polymyalgia rheumatica
Protocol code: EFC18055
Sponsor: Sanofi-Aventis Recherche & Developpement (Pharmaceutical company). Phase: Therapeutic confirmatory (Phase III). Countries: France (authorised, recruitment pending), Netherlands (authorised, recruitment pending), Germany (authorised, recruitment pending), Czechia (ongoing, recruiting), Belgium (authorised, recruitment pending), Austria (authorised, recruitment pending), Hungary (authorised, recruitment pending), Greece (authorised, recruitment pending), Spain (ongoing, recruiting).
Therapeutic area(s): Diseases [C] - Musculoskeletal Diseases [C05]
Gender: Female, Male. Age: 18-64 years, 65+ years. Enrolment: 177.
Start date (EU): 2026-07-15. Decision date: 2026-06-15. Results received: No. Last updated: 2026-08-08.
Decision dates by country: AT: 2026-06-21, BE: 2026-06-15, CZ: 2026-06-17, FR: 2026-06-16, DE: 2026-06-17, HU: 2026-06-16, ES: 2026-06-17, NL: 2026-06-16, GR: 2026-07-27

Condition(s): Musculoskeletal diseases
Product: sarilumab, sarilumab, Prednison 5 mg GALEN® Tabletten, Encorton, 1 mg, tabletki, placebo matching sarilumab

Primary endpoint: Sustained remission at Week 52 (yes/no) in participants with early relapsing polymyalgia rheumatica (PMR) who received sarilumab 200 mg q2w with 52-week prednisone taper
Endpoint(s): Sustained remission at Week 52 (yes/no) in all participants (newly diagnosed PMR and early relapsing PMR) who received sarilumab 200 mg q2w with prednisone taper, Sustained remission at Week 52 (yes/no) in participants with early relapsing PMR, as well as in all participants (newly diagnosed PMR and early relapsing PMR) who received sarilumab 150 mg q2w with prednisone taper, Treatment-emergent adverse events (TEAEs), serious adverse events (SAEs), adverse events of special interest (AESIs), abnormalities in laboratory values, anti-drug antibody, Corticosteroid-free remission at Week 52, Remission at Week 24, Time in remission through Week 52, Incidence rate of flare through Week 52, Change from baseline in PMR activity score and its components at Weeks 24 and 52, Changes from baseline at Weeks 24 and 52 in the physical component summary and mental component summary from Shortform 36-item questionnaire (SF-36v2)

Source: https://euclinicaltrials.eu/ctis-public/view/2024-511296-15-00